EU clinical trial 2024-518821-13-00: A Phase 2b, Multicenter, Randomized, Double-blind, Parallel group, Placebo-controlled, Dose Range Finding Study to Evaluate the Efficacy, Safety, and Tolerability of Nebulized CSL787 in Adults (18 to 85 years) with Non-cystic Fibrosis Bronchiectasis
Protocol code: CSL787_2001
Sponsor: CSL Behring LLC (Pharmaceutical company). Phase: Therapeutic exploratory (Phase II). Countries: Spain (authorised, recruitment pending), Belgium (ended), Germany (authorised, recruitment pending), Greece (ended), Denmark (authorised, recruitment pending), Netherlands (authorised, recruitment pending), Hungary (ended), Italy (authorised, recruitment pending), France (ended), Poland (authorised, recruitment pending).
Therapeutic area(s): Diseases [C] - Respiratory Tract Diseases [C08]
Gender: Female, Male. Age: 18-64 years, 65+ years. Enrolment: 226.
Decision date: 2025-09-26. Results received: No. Last updated: 2026-04-23.
Decision dates by country: BE: 2025-10-01, FR: 2025-09-26, DE: 2025-09-29, GR: 2025-09-29, HU: 2025-09-29, IT: 2025-09-30, NL: 2025-09-30, ES: 2025-10-01, DK: 2025-11-12, PL: 2026-04-23

Condition(s): Non-cystic Fibrosis Bronchiectasis
Product: Placebo, inhalation solution

Primary endpoint: TTF (Time to first) Exacerbation
Endpoint(s): Annualized Exacerbation Rate (AER) (Exacerbation Event Rate Per Participant-year of Follow-up), Number of Participants Achieving a Clinically Important Difference in the Quality of Life–Bronchiectasis (QoL-B) Respiratory Symptoms Scale, Percentage of Participants Achieving a Clinically Important Difference in the QoL-B Respiratory Symptoms Scale, Change From Baseline in QoL-B Respiratory Symptoms Scale, Change From Baseline in Total Colony-forming Unit (CFUs) for Pathogenic Bacteria isolated from Sputum, Number of Participants with Treatment-emergent Adverse events (TEAEs) and Serious Adverse Events (SAEs), Percentage of Participants with TEAEs and SAEs

Source: https://euclinicaltrials.eu/ctis-public/view/2024-518821-13-00